EU clinical trial 2026-525316-33-00: DISCO-RA:DIScontinuation of COncomitant disease modifying anti-rheumatic drugs (DMARDs) in rheumatoid arthritis patients also using TNF inhibitors - a randomized long-term non-inferiority strategy trial
Protocol code: 2025.36
Sponsor: Sint Maartenskliniek Stichting (Hospital/Clinic/Other health care facility). Phase: Therapeutic use (Phase IV). Countries: Netherlands (ongoing, recruiting).
Therapeutic area(s): Diseases [C] - Immune System Diseases [C20]
Gender: Female, Male. Age: 18-64 years, 65+ years. Enrolment: 202.
Status: Ongoing, recruiting. Start date (EU): 2026-06-09. Decision date: 2026-06-09. Results received: No. Last updated: 2026-06-09.

Condition(s): Rheumatoid arthritis
Product: Enbrel 25 mg solution for injection in pre-filled syringe, Hyrimoz 40 mg solution for injection in pre-filled pen, Cimzia 200 mg solution for injection in pre-filled syringe, Metoject 20 mg=0,4 ml oplossing voor injectie, voorgevulde injectiespuit 50 mg/ml, METHOTREXATE, Benepali 50 mg solution for injection in pre-filled syringe, Enbrel 25 mg solution for injection in pre-filled pen, Hukyndra 40 mg solution for injection in pre-filled syringe, Erelzi 25 mg solution for injection in pre-filled syringe., GOBIVAZ 50 mg solution for injection in pre-filled pen., Simponi 100 mg solution for injection in pre-filled pen., Injexate 22,5 mg = 0,45 ml oplossing voor injectie in voorgevulde injector, Erelzi 50 mg solution for injection in pre-filled pen, Hyrimoz 80 mg solution for injection in pre-filled pen, Injexate 7,5 mg = 0,15 ml oplossing voor injectie in voorgevulde injector, Ebetrex 10 mg = 0,5 ml, oplossing voor injectie in voorgevulde injectiespuit 20 mg/ml, Hukyndra 40 mg solution for injection in pre-filled pen, Metoject PEN 12,5 mg=0,25 ml oplossing voor injectie in een voorgevulde pen, Flixabi 100 mg powder for concentrate for solution for infusion, Injexate 17,5 mg = 0,35 ml oplossing voor injectie in voorgevulde injector, Benepali 50 mg solution for injection in pre-filled pen, Humira 80 mg solution for injection in pre-filled pen, LEFLUNOMIDE, METHOTREXATE, Hukyndra 80 mg solution for injection in pre-filled syringe, Inflectra 100 mg powder for concentrate for solution for infusion, Idacio 40 mg solution for injection in pre-filled syringe, Basitrin 12,5 mg=0,333 ml, oplossing voor injectie in een voorgevulde spuit 37,5 mg/ml, METHOTREXATE, GOBIVAZ 100 mg solution for injection in pre-filled pen., Injexate 20 mg = 0,40 ml oplossing voor injectie in voorgevulde spuit, Injexate 17,5 mg = 0,35 ml oplossing voor injectie in voorgevulde spuit, Metoject PEN 17,5 mg=0,35 ml oplossing voor injectie in een voorgevulde pen, Yuflyma 40 mg solution for injection in pre-filled pen, Metoject 25 mg=0,5 ml oplossing voor injectie, voorgevulde injectiespuit 50 mg/ml, Metoject 10 mg=0,2 ml oplossing voor injectie, voorgevulde injectiespuit 50 mg/ml, Basitrin 10 mg=0,267 ml, oplossing voor injectie in een voorgevulde spuit 37,5 mg/ml, Metoject 12,5 mg=0,25 ml oplossing voor injectie, voorgevulde injectiespuit 50 mg/ml, Metoject PEN 10 mg=0,2 ml oplossing voor injectie in een voorgevulde pen, Metoject 22,5 mg=0,45 ml oplossing voor injectie, voorgevulde injectiespuit 50 mg/ml, Metoject PEN 15 mg=0,3 ml oplossing voor injectie in een voorgevulde pen, Basitrin 17,5 mg=0,467 ml, oplossing voor injectie in een voorgevulde spuit 37,5 mg/ml, Metoject 7,5 mg=0,15 ml oplossing voor injectie, voorgevulde injectiespuit 50 mg/ml, Humira 40 mg solution for injection in pre-filled syringe, Cimzia 200 mg solution for injection in pre-filled pen, Metoject PEN 20 mg=0,4 ml oplossing voor injectie in een voorgevulde pen, Erelzi 50 mg solution for injection in pre-filled syringe., Basitrin 22,5 mg=0,600 ml, oplossing voor injectie in een voorgevulde spuit 37,5 mg/ml, Metoject 17,5 mg=0,35 ml oplossing voor injectie, voorgevulde injectiespuit 50 mg/ml, Imraldi 40 mg solution for injection in pre-filled syringe, Remsima 120 mg solution for injection in pre-filled syringe, Metoject PEN 25 mg=0,5 ml oplossing voor injectie in een voorgevulde pen, Ebetrex 7,5 mg = 0,375 ml, oplossing voor injectie in voorgevulde injectiespuit 20 mg/ml, METHOTREXATE, Idacio 40 mg solution for injection in pre-filled pen, Yuflyma 80 mg solution for injection in pre-filled pen, Zessly 100 mg powder for concentrate for solution for infusion, METHOTREXATE, METHOTREXATE, METHOTREXATE, METHOTREXATE, LEFLUNOMIDE, Benepali 25 mg solution for injection in pre-filled syringe, Emthexate PF, oplossing voor injectie 25 mg/ml., Yuflyma 40 mg solution for injection in pre-filled syringe, Ebetrex 20 mg = 1 ml, oplossing voor injectie in voorgevulde injectiespuit 20 mg/ml, Basitrin 7,5 mg=0,200 ml, oplossing voor injectie in een voorgevulde spuit 37,5 mg/ml, Injexate 10 mg = 0,20 ml oplossing voor injectie in voorgevulde injector, Humira 40 mg solution for injection in pre-filled pen, Remsima 40 mg/mL concentrate for solution for infusion, Injexate 15 mg = 0,30 ml oplossing voor injectie in voorgevulde spuit, Arava 10 mg film-coated tablets, AMGEVITA 40 mg solution for injection in pre-filled pen, Injexate 22,5 mg = 0,45 ml oplossing voor injectie in voorgevulde spuit, Injexate 15 mg = 0,30 ml oplossing voor injectie in voorgevulde injector, Ebetrex 25 mg = 1,25 ml, oplossing voor injectie in voorgevulde injectiespuit 20 mg/ml, Basitrin 25 mg=0,667 ml, oplossing voor injectie in een voorgevulde spuit 37,5 mg/ml, Basitrin 20 mg=0,533 ml, oplossing voor injectie in een voorgevulde spuit 37,5 mg/ml, Injexate 12,5 mg = 0,25 ml oplossing voor injectie in voorgevulde spuit, AMGEVITA 40 mg solution for injection in pre-filled syringe, METHOTREXATE, Remsima 120 mg solution for injection in pre-filled pen, Humira 80 mg solution for injection in pre-filled syringe, Enbrel 50 mg solution for injection in pre-filled syringe, Enbrel 25 mg powder and solvent for solution for injection, Ebetrex 12,5 mg = 0,625 ml, oplossing voor injectie in voorgevulde injectiespuit 20 mg/ml, Metoject 15 mg=0,3 ml oplossing voor injectie, voorgevulde injectiespuit 50 mg/ml, Metoject PEN 7,5 mg=0,15 ml oplossing voor injectie in een voorgevulde pen, Enbrel 50 mg solution for injection in pre-filled pen, Remsima 100 mg powder for concentrate for solution for infusion, GOBIVAZ 50 mg solution for injection in pre-filled syringe., Injexate 12,5 mg = 0,25 ml oplossing voor injectie in voorgevulde injector, Simponi 50 mg solution for injection in pre-filled syringe., METHOTREXATE, Imraldi 40 mg solution for injection in pre-filled pen, AMGEVITA 80 mg solution for injection in pre-filled pen, Injexate 25 mg = 0,50 ml oplossing voor injectie in voorgevulde spuit, Injexate 10 mg = 0,20 ml oplossing voor injectie in voorgevulde spuit, Injexate 7,5 mg = 0,15 ml oplossing voor injectie in voorgevulde spuit, Simponi 50 mg solution for injection in pre-filled pen., Basitrin 15 mg=0,400 ml, oplossing voor injectie in een voorgevulde spuit 37,5 mg/ml, Arava 20 mg film-coated tablets, Injexate 20 mg = 0,40 ml oplossing voor injectie in voorgevulde injector, Injexate 25 mg = 0,50 ml oplossing voor injectie in voorgevulde injector, Remicade 100 mg powder for concentrate for solution for infusion., Hyrimoz 40 mg solution for injection in pre-filled syringe, Metoject PEN 22,5 mg=0,45 ml oplossing voor injectie in een voorgevulde pen

Primary endpoint: The primary endpoint is the between-group difference in mean time-weighted DAS28-CRP during 24 months of follow-up. A mean time-weighted DAS28-CRP is chosen to balance the limitations of assessing disease activity at a single timepoint with solely considering the occurrence of flare. The time-weighted DAS28-CRP consists of a weighted average of a patient’s DAS28-CRP scores, calculated using the trapezoid method and weighed by the time interval between measurements.
Endpoint(s): Disease activity measured by DAS28-CRP at 3, 6, 12, 18 and 24 months, Proportion of patients in remission (DAS28-CRP ≤ 2.4) or LDA (DAS28-CRP ≤ 2.9) at 3, 6, 12, 18, and 24 months, Fatigue and pain, measured by the Numeric Pain Rating Scale 0-10 (NRS 0–10), at baseline, 3, 6, 12, 18 and 24 months and at flare visits, Disease impact, measured by Rheumatoid Arthritis Impact of Disease (RAID) questionnaire, at baseline, 3, 6, 12, 18 and 24 months and at flare visits, Disease impact, measured by Patient Acceptable Symptom State (PASS) at baseline, 3, 6, 12, 18 and 24 months and at flare visits, Disease impact, measured by Transition scale at baseline, 3, 6, 12, 18 and 24 months and at flare visits, Medication adherence, measured by Medical Adherence Rating Scale (MARS), at baseline, 3, 6, 12, 18 and 24 months and at flare visits, Change between baseline and 24 months in Simple Erosion Narrowing Score (SENS) for radiographic joint damage, Health Assessment Questionnaire-Disability Index (HAQ-DI) at baseline, 3, 6, 12, 18 and 24 months and at flare visits, Euro Quality of Life 5-Dimensions 5-Levels (EQ-5D-5L) questionnaire at baseline, 3, 6, 12, 18 and 24 months and at flare visits, TNFi and ADA serum levels at baseline, 3 (csDMARD discontinuation group only), and 24 months, Proportion of patients relapsing/restarting combination therapy over 24 months, Flare (DAS28-CRP increase from baseline of >1.2, or >0.6 if current DAS28-CRP >2.9) incidence calculated by cumulative incidence and incidence density (events per person-years) over 24 months, Time-to-event analysis of first flare over 24 months, Frequency and severity of adverse events (AEs) and serious adverse events (SAEs) using the Common Terminology Criteria for Adverse Events version 5 (CTCAEv5) over 24 months, Proportion of patients in the csDMARD discontinuation group using a csDMARD and/or TNFi at 24 months, Proportion of patients who have discontinued the baseline TNFi at month 24, including those who discontinue or switch to another b/tsDMARD at the 24-month visit, Dosing and route of administration of csDMARD and/or TNFi at 24 months, MTX and LEF usage characteristics, including route of administration, use and dosage of folic acid, and other RA-related comedication over 24 months, Medical costs measured using the institute for Medical Technology Assessment Medical Consumption Questionnaire (iMTA MCQ) at baseline, 3, 6, 12, 18 and 24 months, Productivity losses and participation measured using the institute for Medical Technology Assessment Productivity Cost Questionnaire (iMTA PCQ) and Work Productivity and Activity Impairment questionnaire (WPAI) at baseline, 3, 6, 12, 18 and 24 months, Prediction modelling using baseline pharmacological factors (TNFi levels and ADA levels) and drug and ADA levels after discontinuation of csDMARDs (3 months)

Source: https://euclinicaltrials.eu/ctis-public/view/2026-525316-33-00